EU clinical trial 2023-510433-29-00: Phase III study to assess the impact of gemtuzumab ozogamicin, in combination with standard chemotherapy, on the levels of minimal residual disease, in adult patients, aged 18-60 years, with previously untreated, de novo, favorable- intermediate-risk acute myeloid leukemia. AML1819
Sponsor: Fondazione Gimema Franco Mandelli Onlus (Patient organisation/association). Phase: Therapeutic confirmatory (Phase III). Countries: Italy (ongoing, recruiting).
Therapeutic area(s): Diseases [C] - Hemic and Lymphatic Diseases [C15]
Gender: Female, Male. Age: 18-64 years. Enrolment: 414.
Status: Ongoing, recruiting. Start date (EU): 2020-09-24. Decision date: 2025-01-10. Results received: No. Last updated: 2026-05-13.

Condition(s): Favorable-intermediate-risk Acute Myeloid Leukemia
Product: DAUNORUBICIN HYDROCHLORIDE, FLUDARABINE, MYLOTARG 5 mg powder for concentrate for solution for infusion, CYCLOPHOSPHAMIDE, TREOSULFAN, CYTARABINE, BUSULFAN

Primary endpoint: Percentage of MRD negativity after consolidation in patients treated in induction and consolidation with GO
Endpoint(s): Overall Survival (OS) at 24 months, Event Free Survival (EFS) at 24 months, Cumulative incidence of relapse (CIR) at 24 months, Response rate in terms of patients who achieve CR after induction therapy, Safety in terms of number and type of adverse events (AE) and serious AE (SAE), OS, EFS, DFS and CIR in favorable and intermediate risk groups, OS, EFS, DFS and CIR according to the MRD level after induction and consolidation, Response rate, OS, EFS, DFS and CIR according to morphology, cytogenetic and molecular baseline characteristics.

Source: https://euclinicaltrials.eu/ctis-public/view/2023-510433-29-00